EU clinical trial 2024-520290-12-00: TYPER– A Randomized Controlled Study Evaluating the Effectiveness of Typology-based Coaching on Therapy Management for Patients with HR+ HER2- Early Breast Cancer Under Adjuvant Treatment with Ribociclib
Protocol code: IFG-01-2024
Sponsor: Institut fuer Frauengesundheit GmbH (Hospital/Clinic/Other health care facility). Phase: Therapeutic use (Phase IV). Countries: Germany (ongoing, recruiting).
Therapeutic area(s): Diseases [C] - Neoplasms [C04]
Gender: Female, Male. Age: 18-64 years, 65+ years. Enrolment: 548.
Status: Ongoing, recruiting. Start date (EU): 2025-11-04. Decision date: 2025-08-12. Results received: No. Last updated: 2026-04-27.

Condition(s): Hormone receptor–positive (HRpos)/human epidermal growth factor receptor 2–negative (HER2neg) early breast cancer at risk of recurrence
Product: RIBOCICLIB, Kisqali 200 mg film-coated tablets

Primary endpoint: time to permanent treatment discontinuation of ribociclib therapy
Endpoint(s): overall persistence rate at 6, 12 and 36 months of adjuvant ribociclib therapy, relapse- and death-free discontinuation rate at 6,12 and 36 months of adjuvant ribociclib therapy, total time of therapy interruptions within 36 months of ribociclib treatment, surveyed by a patient diary, distress and quality of life assessed via the Functional Assessment of Cancer Therapy—Breast (FACT-B), the EQ-5D/visual analog scale (VAS) questionnaires, and the patient distress thermometer after 3, 6, 9, 12, 24, and 36 months of treatment, frequency of adverse events (AEs) (serious AEs (SAEs) will be reported according to National Cancer Institute (NCI) Common Toxicity Criteria version 5.0), outcomes according to STEEP 2.0 criteria, required health utilities within 12, 24 and 36 months, patient type before coaching and after 12 months of coaching

Source: https://euclinicaltrials.eu/ctis-public/view/2024-520290-12-00